EU clinical trial 2023-505244-18-01: Phase IIa non-randomized open single-arm study, multicentre clinical trial to determine the efficacy and safety of coenzyme Q (Ubiquinol) for patients with mitochondrial disorders and cerebellar ataxias
Protocol code: FSJD-EnergiQ-2023
Sponsor: Fundacio Sant Joan De Deu (Laboratory/Research/Testing facility). Phase: Therapeutic exploratory (Phase II). Countries: Spain (not authorised).
Therapeutic area(s): Diseases [C] - Nervous System Diseases [C10]
Gender: Female, Male. Age: 0-17 years, 18-64 years, 65+ years. Enrolment: 90.
Status: Not authorised. Decision date: 2024-11-26. Results received: No. Last updated: 2024-11-26.

Condition(s): Mitochondrial disorders and/or cerebellar ataxias
Product: Quinol 10 polvo estabilizado, sobres dispersables de 150mg

Primary endpoint: Evaluation of adverse effects related to Ubiquinol based on subject reporting for 18 months. Subject interviews during each visit assessing the presence or absence of adverse events., Change from baseline in the Vineland Adaptive Behaviour Scale, III edition (VABS-III) at month 18
Endpoint(s): Effect on (a) cognitive function, (b) language skills, (c) quality of life, (d) symptom severity, treatment response and efficacy (e) movement disorder severity of 18 months of treatment with Ubiquinol evaluated by the change from baseline in the following assessments at month 18, Usefulness of CoQ10 plasma monitoring during treatment determined by change from baseline in the levels of plasma CoQ10, assessed at Visits V1, V3, V4, V5, and V6, Change from baseline in other biomarkers measured by blood analytical assessments (Visits V1, V3, V5, V6): FGF21, GDF15 analysis in plasma.

Source: https://euclinicaltrials.eu/ctis-public/view/2023-505244-18-01